EU clinical trial 2024-514372-40-00: IOCYTE AMI-3: A Phase 3, Randomized, Double-Blind, Placebo-Controlled, Multicenter Study of Intravenous FDY-5301 in Patients with an Anterior ST-Elevation Myocardial Infarction
Protocol code: FDY-5301-302
Sponsor: Faraday Pharmaceuticals Inc. (Pharmaceutical company). Phase: Therapeutic confirmatory (Phase III). Countries: Portugal (ended), Czechia (ended), Spain (ended), Slovakia (ended), Hungary (ended), Netherlands (ended), Germany (ended), Poland (ended), Italy (ended).
Therapeutic area(s): Diseases [C] - Cardiovascular Diseases [C14]
Gender: Female, Male. Age: 18-64 years, 65+ years. Enrolment: 1817.
Status: Ended. Start date (EU): 2022-04-12. End date (EU): 2025-05-27. End date: 2025-09-04. Decision date: 2024-08-14. Results received: Yes. Last updated: 2025-07-01.
Decision dates by country: CZ: 2024-08-15, DE: 2024-08-16, HU: 2024-08-15, PT: 2024-08-21, SK: 2024-08-15, IT: 2024-09-24, ES: 2024-08-14, NL: 2024-08-15, PL: 2024-08-30

Condition(s): Anterior ST-Elevation Myocardial Infarction
Product: The placebo product is manufactured to visually match the corresponding FDY-5301 injection drug product. It is formulated to match a standard saline solution comprised of Sodium Chloride and Water for Injection.

Primary endpoint: The proportion of subjects who experience either cardiovascular mortality (defined as deaths which are sudden and due to presumed arrhythmia, or deaths due to presumed or confirmed thromboembolic cerebral vascular accident, presumed or confirmed pulmonary embolism, cardiac rupture, heart failure, recurrent myocardial infarction [e.g., remote or stent thrombosis], and deaths due to procedural efforts to treat these defined cardiac events), or a heart failure event through Month 12
Endpoint(s): 1. The proportion of subjects who experience either all-cause mortality or a heart failure event through Month 12, 2. The total number of cardiovascular events defined as cardiovascular mortality and heart failure events through Month 12, 3. The proportion of subjects who experience a composite of the following specified non-fatal cardiovascular events: thromboembolic cerebral vascular accident (CVA), ventricular aneurysm/hemorrhage, recurrent myocardial infarction (e.g., remote or stent thrombosis), or persistent arrhythmia requiring intervention (e.g., ventricular fibrillation, sustained ventricular tachycardia, or bradyarrhythmia requiring intervention) through Month 12, 4. Serum troponin T at Day 3

Source: https://euclinicaltrials.eu/ctis-public/view/2024-514372-40-00